EU clinical trial 2024-519343-15-00: Protocol Title: A Phase 3, Single-arm, Multicenter Study to Evaluate the Efficacy and Safety of UGN-104, a Novel Formulation of UGN-101, for the Treatment of Patients With Low-grade Upper Tract Urothelial Cancer (LG-UTUC)
Protocol code: UT002
Sponsor: Urogen Pharma Ltd. (Pharmaceutical company). Phase: Therapeutic confirmatory (Phase III). Countries: Hungary (authorised, recruiting), Poland (ongoing, recruiting), Romania (ongoing, recruiting), Spain (ongoing, recruiting), Bulgaria (ongoing, recruiting), Latvia (ongoing, recruiting).
Therapeutic area(s): Diseases [C] - Neoplasms [C04]
Gender: Female, Male. Age: 18-64 years, 65+ years. Enrolment: 73.
Start date (EU): 2025-10-08. Decision date: 2025-07-09. Results received: No. Last updated: 2026-08-06.
Decision dates by country: BG: 2025-10-10, PL: 2025-07-14, LV: 2026-04-16, RO: 2025-07-14, HU: 2025-07-09, ES: 2025-07-10

Condition(s): Low-grade Upper Tract Urothelial Cancer
Product: UGN-104

Primary endpoint: CRR, defined as the proportion of patients who achieve CR at the PDE Visit (5 ± 1 weeks after the sixth instillation of UGN-104) as determined by wash urine cytology, ureteroscopy, and for cause biopsy.
Endpoint(s): DOR in patients who achieved CR at the PDE Visit, defined as the time from the date of evidence of CR at the PDE Visit to the earliest date of recurrence, progression or death as determined using the date of cytology, ureteroscopy, or for cause biopsy, or death due to any cause, whichever occurs first., DCR rate at scheduled disease assessment time points, defined as the proportion of patients who achieve CR at the PDE Visit and maintain CR (ie, no detectable disease) up to that particular follow-up disease assessment., Safety and tolerability will be evaluated through the reporting of AEs, including SAEs and AESIs, and through standard clinical and laboratory tests (eg, hematology and chemistry, urinalysis, physical examination, and vital signs)., Concentration data and PK parameters (Cmax, tmax, AUC, t1/2, and λZ)., Exploratory: Changes from baseline in patient scores on the QLQ-C30 and TSQM questionnaires., Exploratory: Proportion of study participants reporting improvement at end of study on the PGI-C. The proportion reporting improvement over time will also be assessed to understand when change occurred.

Source: https://euclinicaltrials.eu/ctis-public/view/2024-519343-15-00